EU clinical trial 2024-519946-54-00: Botox Treatment for Patients with Hidradenitis Suppurativa: A Within-Person, Randomized, Double-blind, Controlled Study
Sponsor: Gentofte Hospital, Frederiksberg Hospital (Hospital/Clinic/Other health care facility). Phase: Therapeutic use (Phase IV). Countries: Denmark (ongoing, recruiting).
Therapeutic area(s): Diseases [C] - Skin and Connective Tissue Diseases [C17]; Diseases [C] - Immune System Diseases [C20]
Gender: Female, Male. Age: 18-64 years, 65+ years. Enrolment: 20.
Status: Ongoing, recruiting. Start date (EU): 2025-04-01. Decision date: 2025-02-25. Results received: No. Last updated: 2026-06-09.

Condition(s): Hidradenitis Suppurativa
Product: Natriumklorid isotonisk "SAD", injektionsvæske, opløsning, Dysport, pulver til injektionsvæske, opløsning 300 enheder, XEOMIN 100 units powder for solution for injection, BOTOX, pulver til injektionsvæske, opløsning 100 Allergan-enheder

Primary endpoint: Reduction in IHS4 score
Endpoint(s): 1. Reduction in number of inflammatory nodules, non-inflammatory nodules and draining tunnels. 2. High treatment satisfaction (NRS 0-10). 3. HiSCR50 achieved. 4. Reduction of HiSQOL. 5. DLQI reduction. 6. Pain reduction. 7. Suppuration reduction. 8. Pruritis reduction. 9. Reduction in patient reported disease severity. 10. If the patient would recommend the treatment to others

Source: https://euclinicaltrials.eu/ctis-public/view/2024-519946-54-00